EU clinical trial 2023-507545-28-00: Safety and efficacy of very short dual antiplatelet therapy followed by P2Y12 inhibitor monotherapy in older patients undergoing percutaneous coronary intervention.
Protocol code: 23-0165
Sponsor: Centre Hospitalier Universitaire De Caen Normandie (Hospital/Clinic/Other health care facility). Phase: Therapeutic use (Phase IV). Countries: France (ongoing, recruiting).
Therapeutic area(s): Diseases [C] - Cardiovascular Diseases [C14]
Gender: Female, Male. Age: 65+ years. Enrolment: 1700.
Status: Ongoing, recruiting. Start date (EU): 2026-03-06. Decision date: 2025-03-27. Results received: No. Last updated: 2025-03-27.

Condition(s): Elderly patients ≥ 65 years successfully treated with percutaneous coronary intervention (PCI) with ≥ 1 drug-eluting stent for acute or chronic coronary syndrome
Product: KARDEGIC 75 mg, poudre pour solution buvable en sachet-dose, Brilique 90 mg film-coated tablets, Plavix 75 mg film-coated tablets, Efient 10 mg film-coated tablets.

Primary endpoint: Net clinical benefit (a composite of all-cause death, myocardial infarction, stroke, and major bleeding defined as BARC grade 3 or 5) non-inferiority at 1 year, H01 BARC=Bleeding Academic Research Consortium
Endpoint(s): 1) Major or clinically relevant non-major bleeding (BARC 2, 3 or 5) non-inferiority, H02, - net clinical benefit (a composite of all-cause death, myocardial infarction, stroke, and major bleeding defined as BARC grade 3 or 5) evaluated as superior or not, - all-cause death, - myocardial infarction type 1, 3 or 4b (type 4b defined according ARC-2 definition), - any stroke, - Intracranial bleeding defined by NeuroARC type 1.a.H, 1.b, 1.c hemorrhagic CNS injury, - cardiovascular death (ARC-2 definition), - stent thrombosis (definite or probable, ARC-2 definition), - All-cause hospitalization, - Urgent/unplanned symptoms-driven coronary revascularization, Evaluation criteria of the study are hemorrhagic or thrombotic safety criteria related to the antiplatelet strategies., 2) Major or clinically relevant non-major bleeding (BARC 2, 3 or 5) superiority, H03, 3) Major cardiovascular and cerebrovascular events (a composite of all-cause death, myocardial infarction and stroke) non-inferiority, H04, 4) Major bleeding (BARC 3 or 5) superiority, H05

Source: https://euclinicaltrials.eu/ctis-public/view/2023-507545-28-00